EU clinical trial 2024-518834-95-02: An open-label, non-randomized, extension study to further investigate the long-term efficacy, safety, and tolerability of Guanabenz in patients with early childhood onset vanishing white matter (VWM)
Sponsor: Amsterdam UMC Stichting (Patient organisation/association). Phase: Phase I and Phase II (Integrated)- Other. Countries: Netherlands (ongoing, recruiting).
Therapeutic area(s): Diseases [C] - Nervous System Diseases [C10]
Gender: Female, Male. Age: 0-17 years, 18-64 years. Enrolment: 30.
Status: Ongoing, recruiting. Start date (EU): 2025-12-08. Decision date: 2025-11-21. Results received: No. Last updated: 2026-06-22.

Condition(s): Vanishing white matter
Product: Guanabenz capsule 24 mg in 480 mg blend 2, Guanabenz capsule 16 mg in 320 mg blend 2, Guanabenz capsule 8 mg in 160 mg blend 2, Guanabenz capsule 1 mg in 90 mg blend 1, Guanabenz capsule 4 mg in 360 mg blend 1, Guanabenz capsule 2 mg in 180 mg blend 1

Primary endpoint: Ambulation: change from baseline at VWM1 study start to the end of the VWM2 study in the ability to walk at least 10 steps without and with light support of one hand as assessed by clinical examination, by the Gross Motor Function Measure, version 88 (GMFM 88), item E, number 68-88 or Health Utility Index (HUI) item 9, score 1-4, depending on available data in historical controls.
Endpoint(s): Overall survival rate., Changes in quality of life (QoL) and disability of participants, measured from the start of VWM1 to the end of VWM2, assessed using: GMFM 88, GMFC-MLD, GMFCS, MACS, CFCS, ELFC-MLD, EDACS, HUI, LIPS, Vineland-3, EQ-5D-5L, and EQ-5D-Y (proxy and self-reporting from 8 years old)., Changes in brain MRI parameters from baseline at VWM1 study start to the end of the VMW2 study: • Diffusion Tensor Imaging (DTI) • Chemical Shift Imaging (CSI) • Neurite Orientation Dispersion and Density Imaging (NODDI) • Myelin Water Fraction Imaging (MWFI), Guanabenz PK parameters in plasma, such as Cmax, AUC, half-life (T1/2), and predicted trough concentration (Ctrough) at steady state, Guanbenz exposure analyzed versus the primary endpoint., Frequency, severity, and daily life impact of all AEs, including AEs of special interest, occurring from the start of VWM2 study treatment until the end of the VWM2 study.

Source: https://euclinicaltrials.eu/ctis-public/view/2024-518834-95-02